EU clinical trial 2024-519010-31-00: A Multicentre, Randomised Phase Ib Trial to evaluate Neoadjuvant Immunotherapy Combination of Nivolumab alone or plus Ipilimumab with the IL-2 Superkine MDNA11 alone or with Tocilizumab in Patients with High-Risk, Surgically Resectable Melanoma – NEO-CYT
Sponsor: Fondazione Melanoma Onlus (Laboratory/Research/Testing facility). Phase: Human Pharmacology (Phase I)- Other. Countries: Italy (authorised, recruitment pending).
Therapeutic area(s): Diseases [C] - Neoplasms [C04]
Gender: Female, Male. Age: 18-64 years, 65+ years. Enrolment: 80.
Status: Authorised, recruitment pending. Decision date: 2025-09-15. Results received: No. Last updated: 2026-08-03.

Condition(s): High-Risk, Surgically Resectable Melanoma

Source: https://euclinicaltrials.eu/ctis-public/view/2024-519010-31-00